EU clinical trial 2026-525953-35-00: Study in healthy volunteers to evaluate how the body processes Iadademstat and if food affects it
Protocol code: CL07-ORY-1001
Sponsor: Oryzon Genomics S.A. (Pharmaceutical company). Phase: Human Pharmacology (Phase I)- Other. Countries: Spain (authorised, recruitment pending).
Therapeutic area(s): Not possible to specify
Gender: Female, Male. Age: 18-64 years, 65+ years. Enrolment: 30.
Status: Authorised, recruitment pending. Decision date: 2026-08-04. Results received: No. Last updated: 2026-08-04.

Condition(s): Healthy Volunteers

Source: https://euclinicaltrials.eu/ctis-public/view/2026-525953-35-00